EU clinical trial 2024-516752-18-00: Exploratory study evaluating the relevance of [68Ga]Ga-PentixaFor for initial staging and therapeutic evaluation of symptomatic multiple myeloma patients in first line treatment or in relapse.
Protocol code: RC19_0289
Sponsor: Centre Hospitalier Universitaire De Nantes (Hospital/Clinic/Other health care facility). Phase: Therapeutic exploratory (Phase II). Countries: France (ongoing, recruitment ended).
Therapeutic area(s): Analytical, Diagnostic and Therapeutic Techniques and Equipment [E] - Diagnosis [E01]
Gender: Female, Male. Age: 18-64 years, 65+ years. Enrolment: 60.
Status: Ongoing, recruitment ended. Start date (EU): 2021-09-21. Decision date: 2024-09-20. Results received: No. Last updated: 2026-06-26.

Condition(s): Multiple myeloma
Product: [68Ga]Ga-PentixaFor

Primary endpoint: Sensitivity will be assessed by patient and lesion analysis by defining: o True positive (TP): - lesion positive with [68Ga]Ga-PentixaFor-PET and confirmed by another imaging method (FDG-PET/CT, CT scan or MRI) and follow-up or confirmed by histology. o False negative (FN): - lesion negative with [68Ga]Ga-PentixaFor-PET and positive by FDG-PET and confirmed by CT or MRI or histology, or confirmed by follow-up.
Endpoint(s): At the time of initial diagnosis or at relapse, the specificity (PPV and NPV) of [68Ga]Ga-PentixaFor-PET at the time of initial diagnosis will be assessed by patient and lesion analysis using the same definitions of TP and FN as for the primary objective., At the time of initial diagnosis or at relapse, the prognostic impact of FDG-PET and [68Ga]Ga-PentixaFor-PET based on the number of lesions detected and their intensity of uptake by each imaging technique will be evaluated by assessing the impact of these data on the PFS and OS. PFS is defined as the time from the start of treatment to relapse or progression. OS is defined as the time from the start of treatment to death., At the time of initial diagnosis or at relapse, we will consider as discordant a lesion positive by FDG-PET but negative by [68Ga]Ga-PentixaFor-PET and/or a lesion negative by FDG-PET but positive by [68Ga]Ga-PentixaFor-PET, At the time of initial diagnosis or at relapse, [68Ga]Ga-PentixaFor and FDG uptakes assessed by SUV and the quantitative expression of biological markers on myelogram (including expression of the gene coding for hexokinases)., At the time of initial diagnosis or at relapse, tolerance of [68Ga]Ga-PentixaFor will be assessed by clinical monitoring of the patient for 1 hour after [68Ga]Ga-PentixaFor injection. Clinical data (heart rate, oxygen saturation and blood pressure) will be collected prior [68Ga]Ga-PentixaFor injection before acquisition (at 60 min) and at the end of acquisition (at approximately 80 min)., At the time of therapeutic evaluation, we will consider as discordant a lesion positive by FDG-PET but negative by [68Ga]Ga-PentixaFor-PET and/or a lesion negative by FDG-PET but positive by [68Ga]Ga-PentixaFor-PET., At the time of therapeutic evaluation, the prognostic impact of [68Ga]Ga-PentixaFor-PET after therapy will be determined by evaluating the impact of a decrease uptake and/or a normalisation of images on PFS and OS., At the time of therapeutic evaluation, PET-FDG, [68Ga]Ga-PentixaFor-PET results (positive/negative) and minimal residual disease evaluated by flow cytometry (positive/negative)., At the time of therapeutic evaluation, tolerance of [68Ga]Ga-PentixaFor will be assessed by clinical monitoring of the patient for 1 hour after [68Ga]Ga-PentixaFor injection. Clinical data (heart rate, oxygen saturation and blood pressure) will be collected prior and 5/10 min after [68Ga]Ga-PentixaFor injection before acquisition (at 60 min) and at the end of acquisition (at approximately 80 min).

Source: https://euclinicaltrials.eu/ctis-public/view/2024-516752-18-00